EU clinical trial 2024-517285-41-00: ALADDIN: evaluation of dAroLutamide Addition to anDrogen Deprivation therapy and radIatioN therapy in newly diagnosed prostate cancer with pelvic lymph nodes metastases
Sponsor: ARTIC (Patient organisation/association). Phase: Therapeutic confirmatory (Phase III). Countries: France (authorised, recruitment pending).
Therapeutic area(s): Diseases [C] - Male Urogenital Diseases [C12]
Gender: Male. Age: 18-64 years, 65+ years. Enrolment: 152.
Status: Authorised, recruitment pending. Decision date: 2024-11-05. Results received: No. Last updated: 2026-03-13.
Decision dates by country: FR: 2024-12-24

Condition(s): Newly diagnosed prostate cancer with pelvic lymph nodes metastases
Product: LEUPRORELIN, Placebo to BAY 1841788 300 mg film-coated tablet, BAY 1841788, DEGARELIX, TRIPTORELIN

Primary endpoint: The failure-free survival is defined as the time from the date of randomization to clinical (new cancer-related symptoms), biochemical (PSA rising above nadir + 2ng/mL, phoenix criteria) or radiological (local relapse or new metastases) progression, death, end of 5-year follow-up period or lost to follow-up, whichever occurs first.
Endpoint(s): • Failure-free survival rates at 5 years., • Metastasis-free survival and Metastasis-free survival rates at 5 years : Metastasis-free survival is defined as the time from the date of treatment initiation to the date of increase in the number of metastatic pelvic lymph nodes, or death due to any cause, whichever is first., Progression-free survival and Progression-free survival rates at 5 years : Progression free survival is defined as the time from the date of treatment initiation to disease progression or death from any whichever is first. A progression is defined by radiological progression or biological progression or a clinical progression., 4. Time to PSA response, Time to PSA progression and PSA response rate (30%, 50%, 90%, undetectable = 0.2 ng/mL), PSA at 6 months and 12 months after completion of radiotherapy and PSA ≥0.1 ng/mL at 6 months and 12 months after completion of radiotherapy, Overall survival and Survival rates at 5 years. Overall survival is defined as the time from treatment initiation to the date of documented death from any cause., Cancer-specific survival and Cancer-specific survival rates. Cancer-specific survival is defined as the time from treatment initiation to the date of documented death from prostate cancer or complication from the treatment, whichever occurs first, Time to pain progression (EVA scale), Toxicities (CTCAE v5.0), Quality of life ( EORTC QLQ-C302 and QLQ-PR253)

Source: https://euclinicaltrials.eu/ctis-public/view/2024-517285-41-00